EU clinical trial 2025-524367-20-00: An open-label, single-arm extension study to evaluate the long-term safety, tolerability, and efficacy of KL1333 (napazimone) in patients with primary mitochondrial disease
Protocol code: KL1333 2025-104B
Sponsor: Pharming Technologies B.V. (Pharmaceutical company). Phase: Therapeutic exploratory (Phase II). Countries: Belgium (ongoing, recruiting), Germany (authorised, recruitment pending), Czechia (authorised, recruitment pending), Spain (authorised, recruitment pending), Denmark (authorised, recruitment pending), Italy (authorised, recruitment pending), France (authorised, recruitment pending).
Therapeutic area(s): Phenomena and Processes [G] - Metabolism [G03]
Gender: Female, Male. Age: 18-64 years, 65+ years. Enrolment: 96.
Start date (EU): 2026-06-30. Decision date: 2026-05-21. Results received: No. Last updated: 2026-08-04.
Decision dates by country: BE: 2026-05-21, CZ: 2026-05-22, DK: 2026-05-22, DE: 2026-05-29, IT: 2026-05-25, FR: 2026-05-26, ES: 2026-05-26

Condition(s): Adult patients with primary mitochondrial disease

Primary endpoint: All safety parameters (including AEs, physical examination, vital signs, ECG, C-SSRS, and safety laboratory [hematology, blood chemistry, and urinalysis])., Occurrence of metabolic decompensation and lactic acidosis or image-verified stroke-like episodes consequent to GI AEs are AESIs and will be monitored throughout the study.
Endpoint(s): Patient-reported mitochondrial fatigue: • PROMIS® Fatigue PMD short form, Functional outcome: • 30-second Sit-to-Stand Test, Patient-reported lower extremity function: • Neuro-QOL Lower Extremity Function (Mobility) - short form, Other patient-reported outcomes: • Patient Global Impression (multiple) - severity and change, Other patient-reported outcomes: • EQ-5D-5L, Global impression of severity of PMD disease expression: • Clinician Global Impression of PMD - severity and change, Assessments of mitochondrial disease progression: • NMDAS, Subscales I-III, Mitochondrial diabetes, subgroup analysis: • HbA1c (in subjects with diabetes)

Source: https://euclinicaltrials.eu/ctis-public/view/2025-524367-20-00